EU clinical trial 2022-501055-87-01: A study evaluating the safety and efficacy of once-weekly dosing of somapacitan in a basket study design in paediatric participants with short stature either born small of gestational age or with Turner syndrome, Noonan syndrome or idiopathic short stature
Protocol code: NN8640-4469
Sponsor: Novo Nordisk A/S (Pharmaceutical company). Phase: Therapeutic confirmatory (Phase III). Countries: Netherlands (ended), Poland (ongoing, recruitment ended), Spain (ongoing, recruitment ended).
Therapeutic area(s): Diseases [C] - Hormonal diseases [C19]
Gender: Female, Male. Age: 0-17 years. Enrolment: 20.
Start date (EU): 2023-05-18. Decision date: 2023-03-27. Results received: No. Last updated: 2026-06-01.
Decision dates by country: NL: 2023-03-27, ES: 2023-03-27, PL: 2023-03-27

Condition(s): Noonan syndrome, Small for gestational age, Idiopathic short stature, Turner’s syndrome
Product: Somapacitan 15 mg/1.5 ml PDS290

Primary endpoint: Number of adverse events (AEs) from week 0 to week 26
Endpoint(s): Number of adverse events (AEs) possibly or probably related to somapacitan from week 0 to week 26, Number of adverse events (AEs) from week 0 to week 156, Height Velocity from week 0 to week 26, Change in Height SDS from week 0 to week 26, Change in Height Velocity SDS from week 0 to week 26, Change in IGF-1 SDS from week 0 to week 26, Change in IGFBP-3 SDS from week 0 to week 26, Weekly average somapacitan concentration (C[avg]) based on population PK analysis from week 0 to week 26

Source: https://euclinicaltrials.eu/ctis-public/view/2022-501055-87-01